EU clinical trial 2024-512927-36-00: A Study of LY4052031 in Participants With Advanced or Metastatic Urothelial Cancer or Other Solid Tumors
Protocol code: LOXO-LNC-24001
Sponsor: Eli Lilly & Co. (Pharmaceutical company). Phase: Human Pharmacology (Phase I)- First administration to humans. Countries: France (temporarily halted), Spain (temporarily halted).
Therapeutic area(s): Diseases [C] - Neoplasms [C04]
Gender: Female, Male. Age: 18-64 years, 65+ years. Enrolment: 95.
Status: Temporarily halted. Start date (EU): 2025-10-30. Decision date: 2024-08-19. Results received: No. Last updated: 2026-06-11.
Decision dates by country: ES: 2024-09-09, FR: 2024-08-19

Condition(s): Advanced or Metastatic Urothelial Carcinoma or Other Solid Tumors

Source: https://euclinicaltrials.eu/ctis-public/view/2024-512927-36-00